EU clinical trial 2024-512276-35-00: Selinexor with alternating bortezomib or lenalidomide plus dexamethasone in transplant ineligible newly diagnosed multiple myeloma patients (SABLe): An Investigator Sponsored Trial
Sponsor: Odense University Hospital (Hospital/Clinic/Other health care facility). Phase: Therapeutic exploratory (Phase II). Countries: Estonia (ongoing, recruiting), Norway (ongoing, recruiting), Denmark (ongoing, recruiting).
Therapeutic area(s): Diseases [C] - Hemic and Lymphatic Diseases [C15]
Gender: Female, Male. Age: 18-64 years, 65+ years. Enrolment: 50.
Status: Ongoing, recruiting. Start date (EU): 2021-08-09. Decision date: 2024-11-04. Results received: No. Last updated: 2025-07-09.
Decision dates by country: DK: 2024-11-04, EE: 2024-11-06, NO: 2024-11-05

Condition(s): Multiple Myeloma
Product: SELINEXOR, BORTEZOMIB, LENALIDOMIDE, DEXAMETHASONE

Primary endpoint: ORR at end of induction, with response defined according to IMWG response criteria
Endpoint(s): VGPR rate at end of induction, MRD negativity by NGS at end of induction, Time to at least PR from start of treatment, Time to at least VGPR from start of treatment, Toxicity rates according to NCI-CTCAE v4.03, Rates of neuropathy according to NCI-CTCAE, Rates of documented thrombosis, Rates of administrated vs planned doses, Number of patients of patients finalizing all 16 cycles of planned induction, Toxicity rates (frequency, severity and interference) during treatment according to NCI PRO-CTCAE registrations, Change from baseline to end of treatment in the key PRO domains of functioning (physical, social and emotional) overall QoL and symptoms of fatigue and nausea, OS, PFS, TNT, Changes in gene expression at baseline from patients responding and not-responding to selinexor

Source: https://euclinicaltrials.eu/ctis-public/view/2024-512276-35-00